EU clinical trial 2023-506697-12-00: MK-8507 Extended Multiple Dose Study
Protocol code: MK-8507-015
Sponsor: Merck Sharp & Dohme LLC (Pharmaceutical company). Phase: Human Pharmacology (Phase I)- Other. Countries: Belgium (ended).
Therapeutic area(s): Diseases [C] - Virus Diseases [C02]
Gender: Female, Male. Age: 18-64 years. Enrolment: 80.
Status: Ended. Start date (EU): 2023-10-20. End date (EU): 2024-05-31. End date: 2024-06-01. Decision date: 2023-10-02. Results received: No. Last updated: 2024-05-30.

Condition(s): HIV-1 infection

Source: https://euclinicaltrials.eu/ctis-public/view/2023-506697-12-00